EU clinical trial 2024-519150-37-00: An phase I study of BI 765063 (a monoclonal antibody) as single agent and in combination with BI 754091 (a PD-1) to characterize safety, pharmacokinetics, pharmacodynamics and preliminary efficacy in patients with advanced solid tumour
Protocol code: 1443-0001
Sponsor: OSE Immunotherapeutics (Pharmaceutical company). Phase: Phase I and Phase II (Integrated)- First administration to humans. Countries: France (ended).
Therapeutic area(s): Diseases [C] - Neoplasms [C04]
Gender: Female, Male. Age: 18-64 years, 65+ years. Enrolment: 78.
Status: Ended. Start date (EU): 2019-05-21. End date (EU): 2025-04-30. Decision date: 2024-12-11. Results received: No. Last updated: 2025-02-24.

Condition(s): Patients with advanced solid tumour

Source: https://euclinicaltrials.eu/ctis-public/view/2024-519150-37-00